EU clinical trial 2024-517307-37-00: TEMPLE - Thiopurine Enhanced Mutations for PD-1/Ligand-1 Efficacy
Sponsor: Rigshospitalet (Hospital/Clinic/Other health care facility). Phase: Phase I and Phase II (Integrated)- First administration to humans. Countries: Denmark (ended).
Therapeutic area(s): Diseases [C] - Neoplasms [C04]
Gender: Female, Male. Age: 18-64 years, 65+ years. Enrolment: 39.
Status: Ended. Start date (EU): 2022-09-01. End date (EU): 2024-12-20. Decision date: 2024-11-11. Results received: No. Last updated: 2024-11-11.

Condition(s): Oncology
Product: MERCAPTOPURINE, TIOGUANINE, Tecentriq 1 200 mg concentrate for solution for infusion

Primary endpoint: Phase Ib: To characterize safety, tolerability, maximum tolerated dose (MTD) and/or recommended Phase 2 dose (RP2D) of Atezolizumab given in combination with 6TG and 6MP, Phase II: To evaluate the anti-tumor activity in terms of objective response rate in patients treated with Atezolizumab, 6TG and 6MP
Endpoint(s): To evaluate the efficacy with respect to Progression Free Survival, Overall Survival, and Duration of Response, Characterization of immune cells in tumor and peripheral blood prior to, during treatment and upon progression, Characterization of the tumor mutational and neoantigen landscape prior to, during treatment, and upon progression using WGS and RNAseq on serial biopsies, Characterization of the tumor mutation and neoantigen landscape in circulating tumor cells (ctDNA) prior to, during treatment, and upon progression, HLA typing determined by germline WGS as predictor of efficacy, Tumor gene expression determined by RNAseq signatures as predictor of efficacy, Sequential shallow whole exome ctDNA sequencing to monitor effect, Gene variants in PD-1 and CTLA-4 as predictors of response to treatment, Correlations between plasma DNA-TG levels and anti-tumor-activity

Source: https://euclinicaltrials.eu/ctis-public/view/2024-517307-37-00